EU clinical trial 2024-517536-22-00: A Phase 1, Open-label, Multicenter, Dose-escalation Study of CK-301 Administered Intravenously as a Single Agent to Subjects with Advanced Cancers
Protocol code: CK-301-101
Sponsor: Checkpoint Therapeutics Inc. (Pharmaceutical company). Phase: Phase I and Phase II (Integrated)- First administration to humans. Countries: Spain (ongoing, recruitment ended), France (ongoing, recruitment ended).
Therapeutic area(s): Diseases [C] - Neoplasms [C04]
Gender: Female, Male. Age: 18-64 years, 65+ years. Enrolment: 63.
Status: Ongoing, recruitment ended. Start date (EU): 2020-09-22. Decision date: 2024-09-24. Results received: No. Last updated: 2025-08-19.
Decision dates by country: ES: 2024-09-24, FR: 2024-09-27

Condition(s): Unresectable or metastatic cutaneous squamous cell carcinoma

Source: https://euclinicaltrials.eu/ctis-public/view/2024-517536-22-00